EU clinical trial 2024-520050-38-00: A Phase 3, Open Label, Multicenter, Randomized Study of First Line Tarlatamab in combination with Durvalumab, Carboplatin and Etoposide versus Durvalumab, Carboplatin and Etoposide in Untreated Extensive Stage Small-Cell Lung Cancer (DeLLphi-312)
Protocol code: 20240178
Sponsor: Amgen Inc. (Pharmaceutical company). Phase: Therapeutic confirmatory (Phase III). Countries: Portugal (ongoing, recruitment ended), Germany (ongoing, recruitment ended), Spain (ongoing, recruitment ended), Italy (ongoing, recruitment ended), Denmark (ended), Netherlands (ongoing, recruitment ended), France (ongoing, recruitment ended), Austria (ongoing, recruitment ended), Greece (ongoing, recruitment ended), Belgium (ongoing, recruitment ended), Hungary (ongoing, recruitment ended), Poland (ongoing, recruitment ended), Romania (ended).
Therapeutic area(s): Diseases [C] - Neoplasms [C04]
Gender: Female, Male. Age: 18-64 years, 65+ years. Enrolment: 129.
Start date (EU): 2025-09-18. Decision date: 2025-09-01. Results received: No. Last updated: 2026-04-28.
Decision dates by country: ES: 2025-09-05, FR: 2025-09-05, DK: 2025-09-01, PT: 2025-09-01, BE: 2025-10-10, PL: 2025-09-08, IT: 2025-09-03, AT: 2025-09-05, RO: 2025-09-08, HU: 2025-09-05, NL: 2025-09-04, DE: 2025-09-04, GR: 2025-09-02

Condition(s): Extensive stage small cell lung cancer (ES-SCLC). Small-cell lung cancer, accounting for 10% to 15% of lung cancer (Rudin et al, 2015), is an aggressive lung cancer subtype with neuroendocrine differentiation and strongly associated with smoking (Koinis et al, 2016). It displays a distinct natural history characterized by a high growth fraction, rapid doubling time and early establishment of widespread metastatic lesions (Gustafsson et al, 2008). Around 70% of patients are diagnosed with ES-SCLC, presenting with distant metastasis or tumor or nodal volume that is too large to be encompassed in a tolerable radiation plan.
Product: MYCOPHENOLATE MOFETIL, ETOPOSIDE, DURVALUMAB, INFLIXIMAB, SILTUXIMAB, Tarlatamab, CARBOPLATIN, Tarlatamab

Primary endpoint: OS, Progression free survival (BICR assessed)
Endpoint(s): PFS, OR, DC, DOR, PFS rate at 6 months, 1 year, and 2 years from randomization OS rate at 6 months, 1 year, 2 years, and 3 years from randomization TTP, Incidence of treatment-emergent adverse events, Serum concentrations of tarlatamab., Incidence of anti-tarlatamab antibody formation.

Source: https://euclinicaltrials.eu/ctis-public/view/2024-520050-38-00